EU clinical trial 2024-519423-24-00: NBI-1065845-MDD3028: A Long-Term, Open-Label Study to Assess the Safety and Tolerability of NBI-1065845 as Adjunctive Treatment in Subjects with Major Depressive Disorder (MDD)
Protocol code: NBI-1065845-MDD3028
Sponsor: Neurocrine Biosciences Inc. (Pharmaceutical company). Phase: Therapeutic confirmatory (Phase III). Countries: Bulgaria (ongoing, recruiting), Poland (ongoing, recruiting), Belgium (ongoing, recruiting), Croatia (ongoing, recruiting), Netherlands (ended), Sweden (ongoing, recruiting), Latvia (ongoing, recruiting), Romania (authorised, recruiting), Lithuania (ongoing, recruiting), Finland (ongoing, recruiting), Hungary (authorised, recruiting), Czechia (ongoing, recruiting), Slovakia (ongoing, recruiting), Estonia (ongoing, recruiting), Italy (authorised, recruiting), Spain (authorised, recruiting).
Therapeutic area(s): Psychiatry and Psychology [F] - Mental Disorders [F03]
Gender: Female, Male. Age: 18-64 years, 65+ years. Enrolment: 327.
Start date (EU): 2025-10-07. Decision date: 2025-07-01. Results received: No. Last updated: 2026-08-07.
Decision dates by country: RO: 2025-07-07, HR: 2025-07-07, PL: 2025-07-07, IT: 2026-01-21, NL: 2025-07-01, BG: 2025-07-04, FI: 2025-07-02, LT: 2025-07-02, HU: 2025-07-07, EE: 2026-02-13, CZ: 2025-07-02, LV: 2025-07-01, SK: 2025-07-01, BE: 2025-07-01, ES: 2026-03-27, SE: 2025-07-01

Condition(s): Major Depressive Disorder
Product: NBI-1065845

Primary endpoint: The occurrence of adverse events (AEs) up to Week 52.

Source: https://euclinicaltrials.eu/ctis-public/view/2024-519423-24-00